EU clinical trial 2023-508502-18-00: DOUBLE PRO-TECT Alport: A confirmatory, multicenter, randomized, double-blind, placebo-controlled clinical trial to assess the effect of Dapagliflozin on the progression of chronic kidney disease in adolescent and young adult patients with Alport syndrome
Protocol code: 2023-01601
Sponsor: Universitaetsmedizin Goettingen (Hospital/Clinic/Other health care facility). Phase: Therapeutic confirmatory (Phase III). Countries: Germany (ongoing, recruiting).
Therapeutic area(s): Not possible to specify
Gender: Female, Male. Age: 0-17 years, 18-64 years. Enrolment: 102.
Status: Ongoing, recruiting. Start date (EU): 2024-03-19. Decision date: 2024-02-07. Results received: No. Last updated: 2026-08-05.
Decision dates by country: DE: 2024-04-03

Condition(s): Alport syndrome
Product: Forxiga 5 mg film-coated tablets, P-Tabletten weiß 7 mm Lichtenstein

Primary endpoint: Change from baseline to 48 weeks in (log transformed) UACR.
Endpoint(s): eGFR change from baseline to Week 52, In adults, change from baseline to Week 48 in SF- 36., In adolescents, change from baseline to Week 48 in PedsQL, Difference between treatment groups in eGFR change from Week 4 eGFR to Week 48 measurement

Source: https://euclinicaltrials.eu/ctis-public/view/2023-508502-18-00